EU clinical trial 2023-509471-17-00: C4221023 - A PHASE 2, RANDOMIZED, OPEN-LABEL STUDY OF ENCORAFENIB AND BINIMETINIB PLUS PEMBROLIZUMAB VERSUS NIVOLUMAB AND IPILIMUMAB IN PARTICIPANTS WITH BRAF V600E/K MUTATION-POSITIVE MELANOMA WHO PROGRESSED DURING OR AFTER PRIOR TREATMENT WITH ANTI−PD-1 THERAPY
Protocol code: C4221023
Sponsor: Pfizer Inc. (Pharmaceutical company). Phase: Therapeutic exploratory (Phase II). Countries: Spain (ended), Germany (ended), Slovakia (ended), Italy (ended), Poland (ended).
Therapeutic area(s): Diseases [C] - Neoplasms [C04]
Gender: Female, Male. Age: 18-64 years, 65+ years. Enrolment: 119.
Status: Ended. Start date (EU): 2023-05-24. End date (EU): 2026-02-02. End date: 2026-02-03. Decision date: 2024-06-07. Results received: No. Last updated: 2025-11-12.
Decision dates by country: PL: 2024-07-18, SK: 2024-06-07, DE: 2024-06-10, ES: 2024-06-07, IT: 2024-07-15

Condition(s): Metastatic or unresectable locally advanced BRAF V600E/K mutation positive melanoma
Product: BINIMETINIB, IPILIMUMAB, NIVOLUMAB, PEMBROLIZUMAB, IPILIMUMAB, ENCORAFENIB

Primary endpoint: ORR, defined as the proportion of participants with a confirmed best overall response of either CR or PR, as determined by investigator assessment per RECIST v1.1 from randomization to the earliest of PD, start of subsequent anticancer therapy, or death due to any cause.
Endpoint(s): PFS, defined as the interval of time between the date of randomization to the earliest date of disease progression, as determined by investigator assessment per RECIST v1.1, or death due to any cause, whichever occurs first., OS, defined as the time from date of randomization to the date of death due to any cause or the last known alive date., DOR, defined as the time from the date of the first documented response (CR or PR) to the earliest date of disease progression, as determined by investigator assessment per RECIST v1.1, or death due to any cause., DCR, defined as the proportion of participants with a confirmed best overall response of CR, PR or SD, as determined by investigator assessment per RECIST v1.1., TTR, defined as the time from the date of randomization to the date of first documented response (CR or PR), as determined by investigator assessment per RECIST v1.1., PFS2, defined as the time from the date of randomization to the date of discontinuation of next-line treatment after first objective disease progression by investigator assessment per RECIST v1.1, second objective disease progression after initiation of next-line treatment, as determined by investigator assessment, or death due to any cause, whichever occurs first., Incidence and severity of AEs, and changes in clinical laboratory parameters, vital signs, and cardiac assessments., EORTC QLQ-C30: change from baseline in the global health status/QoL score and all other subscales scores., EQ-5D-5L: change from baseline in the index score and VAS., BRAF V600E/K VAF and/or overall mean VAF from ctDNA analysis of plasma samples collected at baseline and on treatment.

Source: https://euclinicaltrials.eu/ctis-public/view/2023-509471-17-00